EU clinical trial 2024-510738-42-00: Phase III, open-label, single-dose, multi-center multinational trial investigating a serotype 5 adeno-associated viral vector containing the Padua variant of a codon-optimized human factor IX gene (AAV5-hFIXco-Padua, AMT-061) administered to adult subjects with severe or moderately severe hemophilia B
Protocol code: CSL222_3001
Sponsor: CSL Behring LLC (Pharmaceutical company). Phase: Therapeutic confirmatory (Phase III). Countries: Belgium (ended), Netherlands (ended), Germany (ended), Ireland (ended), Denmark (ended), Sweden (ended).
Therapeutic area(s): Diseases [C] - Hemic and Lymphatic Diseases [C15]
Gender: Male. Age: 18-64 years, 65+ years. Enrolment: 27.
Status: Ended. Start date (EU): 2018-12-03. End date (EU): 2025-03-19. End date: 2025-03-20. Decision date: 2024-08-02. Results received: Yes. Last updated: 2025-02-28.
Decision dates by country: BE: 2024-08-08, DK: 2024-08-06, DE: 2024-08-07, IE: 2024-08-08, NL: 2024-08-02, SE: 2024-08-05

Condition(s): Haemophilia B
Product: Hemgenix 1 x 10^13 genome copies/mL concentrate for solution for infusion

Primary endpoint: ABR comparison between CSL222 (formerly: AMT-061) and prophylaxis for non-inferiority between the lead-in phase and the 52 weeks following stable factor IX expression (months 6-18 post treatment)
Endpoint(s): Endogenous factor IX activity at 6 months after CSL222 dosing, Endogenous factor IX activity at 12 months after CSL222 dosing, Endogenous factor IX activity at 18 months after CSL222 dosing, Annualized consumption of factor IX replacement therapy during the 52 weeks following stable factor IX expression (months 6-18 post-treatment), excluding factor IX replacement for invasive procedures, compared to the lead-in phase, Annualized infusion rate of factor IX replacement therapy during the 52 weeks following stable factor IX expression (months 6-18 posttreatment), excluding factor IX replacement for invasive procedures, compared to the lead-in phase, Proportion of subjects remaining free of previous continuous routine prophylaxis during the 52 weeks following stable factor IX expression (months 6-18 post-treatment), Comparison of the percentage of subjects with trough factor IX activity <12% of normal between the lead in phase and after treatment with CSL222 over the 52 weeks following stable factor IX expression (months 6-18 post-treatment), ABR comparison between CSL222 and prophylaxis for superiority between the lead-in phase and the 52 weeks following stable factor IX expression (months 6-18 post-treatment), Rate of spontaneous bleeding events during the 52 weeks following stable factor IX expression (months 6-18 post-treatment) compared to the lead in phase, Rate of joint bleeding events during the 52 weeks following stable factor IX expression (months 6-18 post treatment) compared to the lead-in phase, Estimated ABR – during the 52 weeks following stable factor IX expression (months 6-18 post-treatment) – as a function of pre-IMP anti-AAV5 antibody titers using the luciferase based NAB assay (as a "correlation" analysis), Correlation of factor IX activity levels during the 52 weeks following stable factor IX expression (months 6-18 post-treatment) with pre-IMP anti-AAV5 antibody titers using the luciferase based NAB assay, Occurrence of (and resolution of) new target joints during the 52 weeks following stable factor IX expression (months 6-18 posttreatment) and resolution of pre-existing target joints following CSL222 dosing, Proportion of subjects with zero bleeds during the 52 weeks following stable factor IX expression (months 6-18 post-treatment), PRO questionnaire scores from the international Physical Activity Questionnaire (iPAQ; total physical activity score) during the 12 months following CSL222 dosing compared with the lead-in phase, PRO questionnaire scores from the EuroQol-5 dimensions-5 levels (EQ 5D 5L) visual analogue scale (VAS) score during the 12 months followingCSL222 dosing compared with the lead-in phase, Secondary safety endpoints - Adverse events - Changes in abdominal ultrasound - Anti-AAV5 antibodies (total [IgM and IgG], neutralizing antibodies) - AAV5 capsid-specific T cells - Anti-factor IX antibodies - Factor IX inhibitors and recovery - Hematology and serum chemistry parameters - ALT/AST levels, and corticosteroid use for ALT/AST increases - Vector DNA in blood and semen - Inflammatory markers: IL-1β, IL-2, IL-6, IFNγ, MCP-1 - Alpha-fetoprotein (AFP)

Source: https://euclinicaltrials.eu/ctis-public/view/2024-510738-42-00